EU clinical trial 2023-508138-33-00: Phase 1/2 Multicenter, Open-label Study to Evaluate Safety, Tolerability, Pharmacokinetics, and Pharmacodynamics of NTLA-3001 in Participants with Alpha-1 Antitrypsin Deficiency (AATD)-Associated Lung Disease
Protocol code: ITL-3001-CL-101
Sponsor: Intellia Therapeutics Inc. (Pharmaceutical company). Phase: Phase I and Phase II (Integrated)- First administration to humans. Countries: Ireland (ended).
Therapeutic area(s): Diseases [C] - Respiratory Tract Diseases [C08]
Gender: Female, Male. Age: 18-64 years, 65+ years. Enrolment: 4.
Status: Ended. End date (EU): 2025-01-09. End date: 2025-01-10. Decision date: 2024-11-18. Results received: Yes. Last updated: 2024-11-18.

Condition(s): Pulmonary emphysema
Product: SERPINA1(human)-AAV8-1 DP, LNP1265 DP

Primary endpoint: 1. Treatment-emergent adverse events (TEAE).
Endpoint(s): 1. PD. Circulating alpha-1 antitrypsin (AAT) protein., 2. PK. Plasma concentration-time profiles and PK parameters of the components of the study intervention., 3. Immunogenicity. Total antibodies (TAb) and neutralizing antibodies (NAb) to AAV., 4. Immunogenicity. Antibodies to AAT protein., 5. Immunogenicity. Anti-drug antibodies to LNP., 6. Immunogenicity. Anti-Cas9 protein antibodies., 7. Shedding (Phase 2 only). AAV VGCN per cell in blood, urine, saliva, and semen samples., 8. Exploratory. St George’s Respiratory Questionnaire & 36-item short form health survey questionnaire (SF-36).

Source: https://euclinicaltrials.eu/ctis-public/view/2023-508138-33-00